EU clinical trial 2024-516213-20-00: A Phase 3, parallel-group, randomized, double-blind, 3-arm, placebo-controlled, multicenter study to investigate the efficacy and safety of subcutaneous sonelokimab in male and female participants aged 18 years and over with active psoriatic arthritis who are naive to biologic DMARDs
Protocol code: M1095-PSA-301
Sponsor: MoonLake Immunotherapeutics AG (Pharmaceutical company). Phase: Therapeutic confirmatory (Phase III). Countries: Hungary (ongoing, recruitment ended), Romania (ongoing, recruitment ended), Spain (ongoing, recruitment ended), Greece (ongoing, recruitment ended), Latvia (ongoing, recruitment ended), Lithuania (ongoing, recruitment ended), Poland (ongoing, recruitment ended), Croatia (ongoing, recruitment ended), Czechia (ongoing, recruitment ended), Finland (ongoing, recruitment ended), Estonia (ongoing, recruitment ended), France (ongoing, recruitment ended), Slovakia (ongoing, recruitment ended), Germany (ongoing, recruitment ended), Bulgaria (ongoing, recruitment ended), Portugal (ongoing, recruitment ended).
Therapeutic area(s): Diseases [C] - Skin and Connective Tissue Diseases [C17]
Gender: Female, Male. Age: 18-64 years, 65+ years. Enrolment: 792.
Status: Ongoing, recruitment ended. Start date (EU): 2025-03-25. Decision date: 2025-03-10. Results received: No. Last updated: 2026-07-22.
Decision dates by country: LV: 2025-03-12, GR: 2025-03-11, DE: 2025-03-13, FI: 2025-03-21, RO: 2025-03-17, HU: 2025-03-14, EE: 2025-03-17, HR: 2025-03-17, PT: 2025-03-13, LT: 2025-03-13, CZ: 2025-03-12, SK: 2025-03-10, FR: 2025-03-10, PL: 2025-03-26, ES: 2025-03-11, BG: 2025-03-12

Condition(s): Psoriatic arthritis
Product: Placebo is a sterile solution in a single use prefilled syringe (pfs) intended for subcutaneous administration, Sonelokimab

Primary endpoint: Proportion of participants achieving ACR50 (ie, ≥50% improvement on the ACR response criteria) at Week 16
Endpoint(s): 1. Proportion of participants achieving ACR20 (ie, ≥20% improvement on the ACR response criteria) at Week 16, 2. Proportion of participants achieving Minimal Disease Activity (MDA) at Week 16, 3. Change from Baseline in Health Assessment Questionnaire—Disability Index (HAQ-DI) at Week 16, 4. Proportion of participants achieving a decrease of ≥90% in the Psoriasis Area and Severity Index (PASI90) response at Week 16 in the subgroup of participants with PsO involving ≥3% body surface area at Baseline, 5. Change from Baseline in SF-36 PCS at Week 16, 6. Change from Baseline to Week 16 in joint/bone structural damage (van der Heijde modified Total Sharp Score), 7. Incidence, relatedness, severity, and seriousness of TEAEs, 8. Withdrawal due to TEAEs, 9. Clinically relevant abnormalities in vital signs (blood pressure and heart rate) and body weight, 10. Clinically relevant abnormalities in 12-lead ECG variables, 11. Clinically relevant abnormalities in laboratory parameters (hematology, biochemistry, and urinalysis)

Source: https://euclinicaltrials.eu/ctis-public/view/2024-516213-20-00